EU clinical trial 2022-501890-38-00: A phase 2b, multinational, randomized, double-blind study to investigate the efficacy and safety of redasemtide (S-005151) compared with placebo in adult participants with acute ischemic stroke
Protocol code: 2138P2231
Sponsor: Shionogi B.V. (Pharmaceutical company). Phase: Therapeutic exploratory (Phase II). Countries: Germany (ended), Denmark (ended), Hungary (ended), Czechia (ended), Belgium (ended), Greece (ended), Finland (ended), Spain (ended), France (not authorised).
Therapeutic area(s): Diseases [C] - Cardiovascular Diseases [C14]
Gender: Female, Male. Age: 18-64 years, 65+ years. Enrolment: 238.
Status: Ended. Start date (EU): 2024-02-16. End date (EU): 2026-06-11. End date: 2026-06-15. Decision date: 2023-07-25. Results received: No. Last updated: 2026-06-25.
Decision dates by country: FR: 2023-07-31, DK: 2023-07-25, BE: 2023-07-27, HU: 2023-07-31, FI: 2023-07-27, DE: 2023-07-26, CZ: 2023-07-25, ES: 2023-07-28, GR: 2023-07-27

Condition(s): acute ischemic stroke
Product: Placebo to match S-005151, S-005151

Primary endpoint: mRS score at Day 90
Endpoint(s): 1.Proportion of participants with mRS score of 0 to 2 at Day 90, 2.Proportion of participants with BI score ≥ 95 at Day 90, 3.mRS score at Day 30, 4.mRS score at Day 180, 5.Proportion of participants with mRS score of 0 or 1 at each visit, 6.Proportion of participants with mRS score of 0 to 2 at each visit except Day 90, 7.Proportion of participants with mRS score of 5 or 6 at each visit, 8.Proportion of participants with NIHSS score of 0 or 1 at each visit, 9.Proportion of participants with improvement from baseline of at least 8 points in NIHSS score at each visit, 10.Proportion of participants with NIHSS score deterioration of at least 4 points from baseline at each visit, 11.Change from baseline in NIHSS score at each visit, 12.Proportion of participants with BI score ≥ 95 at each visit except Day 90, 13.Change from Day 5 in SF-36 at each visit, 14.Change from Day 5 in SAQoL-39g at each visit, 15.PGI-C at each visit, 16.Change from Day 5 in PGI-S at each visit, 17.TEAEs, clinical laboratory tests, vital sign measurements (blood pressure, body temperature, respiratory rate, and pulse rate), ECGs and C-SSRS.

Source: https://euclinicaltrials.eu/ctis-public/view/2022-501890-38-00